EU clinical trial 2024-515766-13-00: Multicentre, randomised, double-blind, Phase IIb study to evaluate the safety and efficacy of intralesional administration of two doses of expanded adipose tissue allogeneic adult mesenchymal stem cells (AdMSCs ), conditioned in hyaluronic acid hydrogel, as a treatment for patients with faecal incontinence.
Protocol code: ALOFEC-2019
Sponsor: Fundacion Publica Andaluza Para La Investigacion De Malaga En Biomedicina Y Salud (Laboratory/Research/Testing facility). Phase: Therapeutic exploratory (Phase II). Countries: Spain (authorised, recruitment pending).
Therapeutic area(s): Analytical, Diagnostic and Therapeutic Techniques and Equipment [E] - Therapeutics [E02]
Gender: Female, Male. Age: 18-64 years, 65+ years. Enrolment: 68.
Status: Authorised, recruitment pending. Decision date: 2024-12-18. Results received: No. Last updated: 2026-05-05.

Condition(s): Fecal incontinence
Product: ALOFEC-60, ALOFEC-120

Primary endpoint: A) Safety variables: All clinical adverse events will be collected during follow-up at the same times as the clinical assessment. The cumulative incidence of adverse events attributed to study therapy at 12 months post-treatment will be assessed as the primary endpoint., B) Variables that measure clinical efficacy by assessing the severity of incontinence: Changes from baseline (pre-implantation) measurement of:, Jorge-Wexner test score. Scales for assessing the degree of incontinence are numerous and vary in complexity. The Jorge-Wexner test provides a simple and objective assessment of both stool characteristics and frequency of incontinence episodes, where 0 represents perfect continence and 20 represents the highest degree of incontinence. It will be calculated preoperatively and when appropriate according to visits., Number of episodes of faecal incontinence of loose or solid stools (based on data from the patient's defecation diary)., Score on the faecal incontinence quality of life scale, a survey validated by the American Association of Colorectal Surgeons and recently by the Spanish Digestive Surgeons, which has been adapted and validated in its Spanish version. The 29 questions are divided into 4 different health domains: lifestyle, behaviour, depression/self-perception and embarrassment. Responses to each question are scored from 1 to 5, with 1 indicating the worst quality of life status., Anal manometry: Measures the anal pressure profile using a manometer. Parameters of interest (mm Hg): Maximum basal pressure, maximum voluntary contraction pressure, anal canal length, inhibitory recto-anal reflex, rectal sensitivity. It will be used to know the basal pressure state of the patient's sphincter and rectal complex, and thus be able to compare these parameters after treatment, allowing us to know if it has had any impact and where (sphincter or rectal sensitivity).
Endpoint(s): A) Other clinical efficacy variables (imaging variables): 3D endorectal ultrasound: a ir prminimally invasive scan that allows ultrasound imaging of the layers of the rectal wall, anal sphincters and the organs around the rectum and anus, and allows ultrasound monitoring of lesions and theognostic evolution. It is performed according to Starck's classification. Proctoscopy: Inflammation, ulceration, normal. Rectoscopy: Inflammation, ulcer, normal., B) Efficacy variables for analysis purposes: Changes in the use of continence-enhancing drugs: the use of continence-enhancing drugs will be collected in the CRD to assess the differences between the two groups with respect to the following parameters: 1 Number of patients reaching the clinical condition that enables withdrawal of previously prescribed continence-enhancing drugs. Time to reach this condition, B) Efficacy variables for analysis purposes: Changes in the use of continence-enhancing drugs: the use of continence-enhancing drugs will be collected in the CRD to assess the differences between the two groups with respect to the following parameters: 2 Number of patients who need to initiate the administration of continence-enhancing drugs during follow-up, if they were not prescribed at inclusion. Time to reach this condition, C) Therapy feasibility variable: • It will be collected in the CRD if the procedure of administration of the cellular product/comparator, was performed correctly, without incidences or complications, recording in the same any incidence or complication that took place.

Source: https://euclinicaltrials.eu/ctis-public/view/2024-515766-13-00